EU clinical trial 2024-510580-28-00: NORAD01 - Non inferiority multicenter phase III randomized trial comparing preoperative chemotherapy only to chemotherapy followed by chemoradiotherapy for locally advanced resectable rectal cancer (intergroup FRENCH-GRECCAR- PRODIGE).
Sponsor: Assistance Publique Hopitaux De Paris (Hospital/Clinic/Other health care facility). Phase: Therapeutic confirmatory (Phase III). Countries: France (ongoing, recruiting).
Therapeutic area(s): Diseases [C] - Digestive System Diseases [C06]
Gender: Female, Male. Age: 18-64 years, 65+ years. Enrolment: 540.
Status: Ongoing, recruiting. Start date (EU): 2019-06-05. Decision date: 2024-05-21. Results received: No. Last updated: 2026-04-17.

Condition(s): Middle or low locally advanced resectable rectal carcinoma
Product: IRINOTECAN, FLUOROURACIL, OXALIPLATIN, CALCIUM LEVOFOLINATE, CALCIUM FOLINATE

Primary endpoint: The main endpoint of this phase III study is 3-year progression-free survival from the time to randomization.

Source: https://euclinicaltrials.eu/ctis-public/view/2024-510580-28-00